EU clinical trial 2022-501710-62-02: TRANSCRIPT: An open label, controlled, randomized multicentric international study evaluating the benefit of autologous stem cell transplantation after complete response in frontline setting patients with T cell-lymphoma
Protocol code: TRANSCRIPT
Sponsor: Lysarc (Pharmaceutical company). Phase: Therapeutic use (Phase IV). Countries: Belgium (ongoing, recruiting), France (ongoing, recruiting).
Therapeutic area(s): Diseases [C] - Neoplasms [C04]
Gender: Female, Male. Age: 18-64 years. Enrolment: 204.
Status: Ongoing, recruiting. Start date (EU): 2023-06-07. Decision date: 2023-04-03. Results received: No. Last updated: 2026-03-24.
Decision dates by country: BE: 2023-04-03, FR: 2024-03-29

Condition(s): Peripheral T-cell lymphoma (PTCL)
Product: Etoposide Accord Healthcare 20 mg/ml Solution à diluer pour perfusion, Doxorubicin Accord Healthcare 2 mg/ml solution à diluer pour perfusion, VINCRISIN 1 mg/ml solution injectable, 1 mg, METHYLPREDNISOLONE VIATRIS 40 mg, poudre pour solution injectable (IM-IV), VEPESID 100 mg capsule molle, CORTANCYL 20 mg, comprimé sécable, ADCETRIS 50 mg powder for concentrate for solution for infusion, Cyclofosfamide Accord 500 mg poudre pour solution injectable/pour perfusion

Primary endpoint: Modified progression-free survival (mPFS)
Endpoint(s): Overall survival (OS), Overall response rate (ORR) according to the IWC (International Workshop Criteria) Lugano 2014, Complete response rate (CRR) according to the IWC (International Workshop Criteria) Lugano 2014, Duration of Response (DoR)

Source: https://euclinicaltrials.eu/ctis-public/view/2022-501710-62-02